EU clinical trial 2024-516153-52-00: A Two-cohort, Open-label, Single-arm, Multicenter Study to Evaluate Efficacy, Safety and Tolerability, Pharmacokinetics and Pharmacodynamics of Emapalumab in Children and Adults with Macrophage Activation Syndrome (MAS) in Still's Disease (Including Systemic Juvenile Idiopathic Arthitis and Adult Onset Still's Disease) or with MAS in Systemic Lupus Erythematosus
Protocol code: NI-0501-14
Sponsor: Swedish Orphan Biovitrum AG (Pharmaceutical company). Phase: Phase II and Phase III (Integrated). Countries: Italy (ended), Czechia (ended), Netherlands (ended).
Therapeutic area(s): Diseases [C] - Immune System Diseases [C20]
Gender: Female, Male. Age: 0-17 years, 18-64 years, 65+ years. Enrolment: 15.
Status: Ended. Start date (EU): 2022-03-28. End date (EU): 2025-03-05. End date: 2025-06-04. Decision date: 2024-09-19. Results received: Yes. Last updated: 2025-04-30.
Decision dates by country: CZ: 2024-09-19, IT: 2024-09-24, NL: 2024-09-30

Condition(s): Macrophage activation syndrome (MAS) in the context of Systemic Juvenile Idiopathic Arthritis (sJIA) and Adult onset Still's disease (AOSD). MAS in the context of pediatric and adult Systemic Lupus Erythematosus (SLE).
Product: NI-501; emapalumab, NI-501; emapalumab

Primary endpoint: Proportion of patients with complete response (CR) at Week 8 after first administration of emapalumab.
Endpoint(s): GCs tapering to a dose < 50 % of prednisolone (PDN) equivalent at the time of emapalumab start or to the same (or lower) dose being administered before the occurrence of MAS (in patients already treated for the underlying condition) whichever occurs first at any time during the study., GCs tapering to ≤ 1 mg/kg/day of PDN equivalent at any time during the study., Time to achieve GCs tapering as defined in the 2 bullets above., Time to first CR., Proportion of patients with overall response (OR) as defined by CR or PR (partial response)., Time to first overall response (OR) as defined by CR or PR., MAS recurrence at any time after achievement of CR., Withdrawal from the study due to lack of response as per Investigator decision., Survival time.

Source: https://euclinicaltrials.eu/ctis-public/view/2024-516153-52-00